EU clinical trial 2025-521904-23-00: An Open-label, Multinational Study Assessing the Efficacy and Safety of Dato-DXd Treatment in Patients With HR-positive, HER2 IHC 0, Locally Advanced Inoperable or Metastatic Breast Cancer Refractory to Endocrine Therapy (TROPION-Breast06)
Protocol code: D9260C00003
Sponsor: AstraZeneca AB (Pharmaceutical company). Phase: Therapeutic exploratory (Phase II). Countries: Spain (ongoing, recruiting), France (ongoing, recruiting), Italy (ongoing, recruiting).
Therapeutic area(s): Diseases [C] - Neoplasms [C04]
Gender: Female, Male. Age: 18-64 years, 65+ years. Enrolment: 50.
Status: Ongoing, recruiting. Start date (EU): 2026-02-17. Decision date: 2025-11-05. Results received: No. Last updated: 2026-07-14.
Decision dates by country: ES: 2025-11-07, IT: 2025-11-05, FR: 2025-11-10

Condition(s): Locally Advanced Inoperable or Metastatic Breast Cancer Refractory to Endocrine Therapy
Product: Datopotamab deruxtecan

Primary endpoint: PFS is defined as time from date of first dose of study intervention until progression per RECIST 1.1 as assessed by the investigator or death due to any cause. The analysis will include all dosed participants. All events will be included, regardless of whether the participant withdraws from therapy, receives another anticancer therapy, or experiences clinical progression prior to RECIST 1.1.
Endpoint(s): Proportion of participants with oral mucositis/stomatitis . Proportion of participants with ocular surface events. Proportion of participants with Grade 3 or higher AEs possibly related to Dato-DXd treatment (Grade ≥ 3 treatment-related AEs) according to NCI CTCAE 5.0., CBR at 24 weeks is defined as the percentage of participants who have a confirmed CR or PR or who have SD per RECIST 1.1 as assessed by the investigator and derived from the raw tumour data for at least 24 weeks after date of first dose., ORR is defined as the proportion of participants with measurable disease at baseline who have a confirmed CR or confirmed PR, as assessed by the investigator and derived from raw tumour data per RECIST 1.1. The analysis will include all dosed participants with measurable disease at baseline., DoR will be defined as the time from the date of first documented confirmed response until date of documented progression per RECIST 1.1 as assessed by the investigator or death due to any cause. The analysis will include all dosed participants who have a confirmed response., OS defined as the time from the date of the first dose of study intervention until the date of death due to any cause. The analysis will include all dosed participants. All deaths will be included, regardless of whether the participant withdraws from therapy or receives another anticancer therapy. The measure of interest is the OS rate at 6 months.

Source: https://euclinicaltrials.eu/ctis-public/view/2025-521904-23-00